EU clinical trial 2024-511549-20-00: A Phase 2b, randomized, double-blind, placebo-controlled, multicenter study to assess the efficacy and safety of 3 subcutaneous dose regimens of lunsekimig (SAR443765) in adult participants with moderate to-severe atopic dermatitis
Protocol code: DRI18252
Sponsor: Sanofi-Aventis Recherche & Developpement (Pharmaceutical company). Phase: Therapeutic exploratory (Phase II). Countries: Czechia (ended), Poland (ended).
Therapeutic area(s): Diseases [C] - Immune System Diseases [C20]
Gender: Female, Male. Age: 18-64 years, 65+ years. Enrolment: 108.
Status: Ended. Start date (EU): 2025-04-22. End date (EU): 2026-04-09. End date: 2026-04-10. Decision date: 2025-04-09. Results received: No. Last updated: 2025-08-04.
Decision dates by country: PL: 2025-04-14, CZ: 2025-04-09

Condition(s): Dermatitis atopic
Product: SAR443765 / LUNSEKIMIG, Matched Placebo to Test

Primary endpoint: Percent change in Eczema Area and Severity Index (EASI) score from baseline to Week 24
Endpoint(s): Proportion of participants achieving EASI 75 at Week 24, Proportion of participants with a Validated Investigator Global Assessment Scale for Atopic Dermatitis (vIGA AD) score of 0 (clear) or 1 (almost clear) and a reduction from baseline of ≥2 points at Week 24, Proportion of participants with reduction (improvement) of ≥4 in the weekly average of daily Peak Pruritis-Numerical Rating Scale (PP-NRS) score from baseline to Week 24, Absolute change from baseline in EASI score at Week 24, Percent change from baseline in EASI score throughout the study, Proportion of participants with a vIGA-AD score of 0 (clear) or 1 (almost clear) at Week 24, Proportion of participants with a response of vIGA AD 0 or 1 and a reduction from baseline of ≥2 points throughout the study, Percent change in the weekly average of daily PP NRS scores from baseline to Week 24, Percent change in the weekly average of daily sleep disturbance NRS score from baseline to Week 24, Percent change in the weekly average of daily skin pain NRS score from baseline to Week 24, Change in percent Body Surface Area (BSA) affected by Atopic Dermatitis from baseline to Week 24, Proportion of participants achieving EASI 50 at Week 24, Proportion of participants achieving EASI 90 at Week 24, Proportion of participants with improvement (reduction) of ≥4 points in the weekly average of daily PP NRS scores from baseline throughout the study, Proportion of participants with improvement (reduction) of ≥4 points in the weekly average of daily Sleep Disturbance NRS scores from baseline to Week 24, in participants with a baseline weekly average of daily Sleep Disturbance NRS scores of ≥4 points, Proportion of participants with improvement (reduction) of ≥4 points in the weekly average of daily Skin Pain NRS scores from baseline to Week 24, in participants with a baseline weekly average of daily Skin Pain NRS scores of ≥4 points, Percent change in Scoring of Atopic Dermatitis (SCORAD) Index from baseline to Week 24, Proportion of participants with an improvement of ≥4 points in Dermatology Life Quality Index (DLQI) score from baseline to Week 24 and throughout the study, Percent change in Dermatology Life Quality Index (DLQI) score from baseline to Week 24 and throughout the study, Percent change in Patient Oriented Eczema Measure (POEM) score from baseline to Week 24, Percent change in Hospital Anxiety and Depression Scale (HADS) from baseline to Week 24, Incidence of Antidrug antibody (ADA) against lunsekimig up to end of study, Serum concentrations of lunsekimig throughout the study, Serum concentrations of lunsekimig in the pharmacokinetic/pharmacodynamics (PK/PD) subgroup throughout the study, Number of participants with treatment-emergent adverse events (TEAEs), including local reactions, adverse events of special interest (AESIs), and serious adverse events (SAEs)

Source: https://euclinicaltrials.eu/ctis-public/view/2024-511549-20-00